EU clinical trial 2023-504480-17-00: Clinical impact of pharmacokinetic monitoring of antibiotics in critically ill patients
Protocol code: IIBSP-TDM-2023-28
Sponsor: Fundacio Institut De Recerca De L Hospital De La Santa Creu I Sant Pau (Hospital/Clinic/Other health care facility). Phase: Therapeutic use (Phase IV). Countries: Spain (authorised, recruitment pending).
Therapeutic area(s): Diseases [C] - Bacterial Infections and Mycoses [C01]
Gender: Female, Male. Age: 18-64 years, 65+ years. Enrolment: 384.
Status: Authorised, recruitment pending. Decision date: 2023-07-10. Results received: No. Last updated: 2024-03-11.

Condition(s): Critical Patients admitted to the ICU
Product: DAPTOMYCIN, MEROPENEM, CEFEPIME, LINEZOLID, PIPERACILLIN

Primary endpoint: - Days of admission to ICU - Days of hospital admission - Days on mechanical ventilation - Days on vasoactive drug treatment - Fever - Biomarkers: procalcitonin and C-reactive protein - SOFA scale. Includes Glasgow scale, oxygen saturation, FIO2, mean arterial pressure, dobutamine use, dopamine dose, noradrenaline dose, daily diuresis (measured on days 1, 3, 7 and end of treatment) - Mortality at 30 days.
Endpoint(s): Sociodemographics: age, sex, weight, height, medical service (intensive care, coronary unit, anaesthesia)., Initial clinical data: Charlson index, 10-year survival according to Charlson, presence of relevant comorbidities (diabetes mellitus, heart failure, chronic obstructive pulmonary disease, chronic renal failure, active neoplasia, chronic treatment with corticosteroids, immunosuppressants or chemotherapy, solid organ or haematopoietic progenitor transplant recipients, liver cirrhosis), APACHEII, SAPSII, reason for admission........., Treatment data: antibiotic administered (duration of treatment, dosing regimen, dose and time of administration), date and time of antibiotic initiation, antibiotic used previously (only up to the previous day), concomitant anti-infectives used., Other analytical variables (day of start of treatment, day 3 and day 7 of treatment and end of treatment): urea, creatinine, bilirubin, aspartate transaminase (AST) and alanine transaminase (ALT) enzymes, alkaline phosphatase (ALP), gamma glutamyl transpeptidase (GGT), creatinine kinase (CK), albumin, haemoglobin, haematocrit, platelets, leukocytes, neutrophils, activated partial thromboplastin time (aPTT) and volume, collection time and urine creatinine if performed during treatment., Other clinical data during follow-up: positive cultures (sample, microorganism, sensitivity and MIC if tested), Clostridium difficile toxin detection, water balance, ECMO, ventricular assist or renal replacement therapy (RRT) including duration, type and modality and regimen in case of continuous RRT., Intervention data: number of interventions, date and time of intervention, dosing regimen and administration time after intervention, estimated pharmacokinetic parameters (minimum or trough concentration, maximum or peak concentration, area under the 24-hour curve, volume of distribution, half-life).

Source: https://euclinicaltrials.eu/ctis-public/view/2023-504480-17-00